EU clinical trial 2024-510774-24-00: A randomized, open-label, single dose, cross-over study to evaluate the drug-drug interaction between Proscar 5 mg, film-coated tablets and Cialis 5 mg film-coated tablets when co-administered versus the administration of each product alone in healthy volunteers under fasting conditions. Study no. FIN-TAD-DDI-03-24
Sponsor: Adamed Pharma S.A. (Pharmaceutical company). Phase: Human Pharmacology (Phase I)- Other. Countries: Czechia (ended).
Therapeutic area(s): Diseases [C] - Male Urogenital Diseases [C12]
Gender: Male. Age: 18-64 years. Enrolment: 30.
Status: Ended. Start date (EU): 2024-03-25. End date (EU): 2024-05-07. Decision date: 2024-03-11. Results received: No. Last updated: 2024-03-12.

Condition(s): healthy male subjects

Source: https://euclinicaltrials.eu/ctis-public/view/2024-510774-24-00